EU clinical trial 2024-517579-19-00: Phase I Study of PM54 Administered to Patients with Advanced Solid Tumors
Protocol code: PM54-A-002-24
Sponsor: Pharma Mar S.A. (Pharmaceutical company). Phase: Human Pharmacology (Phase I)- Other. Countries: Spain (ongoing, recruiting).
Therapeutic area(s): Diseases [C] - Neoplasms [C04]
Gender: Female, Male. Age: 18-64 years, 65+ years. Enrolment: 120.
Status: Ongoing, recruiting. Start date (EU): 2025-03-24. Decision date: 2025-03-08. Results received: No. Last updated: 2026-06-11.

Condition(s): Selected Advanced Solid Tumors

Source: https://euclinicaltrials.eu/ctis-public/view/2024-517579-19-00